EU clinical trial 2022-502492-32-00: A Global, Phase 1/2 Study to Evaluate the Safety, Tolerability, Pharmacodynamics, and Pharmacokinetics of mRNA-3705 in Participants with Isolated Methylmalonic Acidemia Due to Methylmalonyl-CoA Mutase Deficiency
Protocol code: mRNA-3705-P101
Sponsor: Moderna Inc. (Pharmaceutical company). Phase: Phase I and Phase II (Integrated)- First administration to humans. Countries: France (ended), Netherlands (ended), Spain (ended).
Therapeutic area(s): Phenomena and Processes [G] - Metabolism [G03]
Gender: Female, Male. Age: 0-17 years, 18-64 years. Enrolment: 30.
Status: Ended. Start date (EU): 2023-02-03. End date (EU): 2025-12-10. End date: 2026-04-01. Decision date: 2024-05-28. Results received: No. Last updated: 2025-12-11.
Decision dates by country: NL: 2024-05-28, FR: 2024-05-28, ES: 2024-05-29

Condition(s): Isolated Methylmalonic Acidemia Due to Methylmalonyl-CoA Mutase Deficiency
Product: 0.9% Sodium Chloride Injection, mRNA-3705

Primary endpoint: Part I: Incidence and severity of TEAEs, including study drug–related and not related TEAEs, AESIs, SAEs, and TEAEs leading to treatment discontinuation., Part II: Percentage change in plasma methylmalonic acid levels at 3 months of treatment in participants treated with mRNA-3705 compared to placebo., Part III: Incidence and severity of TEAEs, including study drug-related and not related TEAEs, AESIs, SAEs, and TEAEs leading to treatment discontinuation.
Endpoint(s): Part I: - Percentage change in plasma methylmalonic acid levels from baseline (pretreatment) to postdose levels measured after single and repeated administrations of mRNA-3705. - Estimation of PD parameters after single and repeated administrations of mRNA-3705, including AUC_Below_B, AUC_Net_B, and Emax - Percentage change in plasma 2-MC levels from baseline (pretreatment) to levels measured after single and repeated administrations of mRNA-3705., Part I (continuation): - Estimation of hMUT mRNA PK parameters including, but not limited to, Cmax, Tmax, AUC, t½, CL, Vz and Vss. - Presence and titers of anti-PEG antibodies., Part II: - Estimation of PK parameters of hMUT (anti-hMUT) mRNAs including, but not limited to, Cmax, Tmax, AUC, t½, CL, and Vz. - Measurement of SM-86 after single and repeated dosing., Part II(continuation): - Percentage change in plasma 2-MC at 3 months of treatment in participants treated with mRNA-3705 compared to placebo. - Change from baseline in PedsQL™ Physical Function score at 3 months of treatment in participants treated with mRNA-3705 compared to placebo. - Annualized frequency of MMA -related hospitalizations up until 3 months of treatment. - Annualized frequency of MDEs up until 3 months of treatment, both overall and by severity., Part II(continuation): - Change in: − PedsQL™ Total Score from baseline(pretreatment) − IGA-S and CrGI-S from baseline(pretreatment) − IGA-I and CrGI-I from the Dose 2 visit - Incidence and severity of TEAEs. - Incidence and severity of SAEs. - Incidence and severity of AESIs (eg, IRR and hypersensitivity). - Incidence and severity of TEAEs leading to treatment discontinuation. - Presence and titers of antibodies against PEG (anti-PEG) and hMUT (anti-hMUT)., Part III: - Percentage change in plasma methylmalonicacid levels at 3 months of treatment - Percentage change in plasma 2-MC levels at 3months of treatment - Estimation of hMUT mRNA PK parametersincluding, but not limited to, Cmax, Tmax, AUC, t½, CL, and Vz - Change from Baseline in PedsQL™ PhysicalFunction score at 3 months of treatment - Annualized frequency of MMA-relatedhospitalizations up until 3 months of treatment, Part III: - Annualized frequency of MDEs up until 3months of treatment, both overall and by severity - Change in: − PedsQL™ Total Score from baseline(pretreatment). − IGA-S and CrGI-S from baseline(pretreatment). − IGA-I and CrGI-I from the Dose 2 visit - Presence and titers of antibodies against PEG(anti-PEG) and hMUT (anti-hMUT)

Source: https://euclinicaltrials.eu/ctis-public/view/2022-502492-32-00